EU clinical trial 2023-507875-23-00: NOvel Immunotherapy strategies for advanced Triple negative breast Cancer (TNBC) patients: TONIC-3 trial
Sponsor: Het Nederlands Kanker Instituut-Antoni van Leeuwenhoek Ziekenhuis Stichting (Hospital/Clinic/Other health care facility). Phase: Therapeutic exploratory (Phase II). Countries: Netherlands (ongoing, recruiting).
Therapeutic area(s): Diseases [C] - Neoplasms [C04]
Gender: Female, Male. Age: 18-64 years, 65+ years. Enrolment: 60.
Status: Ongoing, recruiting. Start date (EU): 2024-06-12. Decision date: 2024-01-15. Results received: No. Last updated: 2024-08-19.

Condition(s): advanced TNBC, eg. irresectable recurrent disease or metastatic disease
Product: Tecentriq 1 200 mg concentrate for solution for infusion, Tiragolumab, YERVOY 5 mg/ml concentrate for solution for infusion

Primary endpoint: Progression-free survival rate as measured by the proportion of patients free of progression after 12-weeks of treatment (PFS: time from administration of first treatment to tumor progression or death from any cause) according to RECIST1.1, Adverse events as measured according to CTCAE v5.0 and immune-related toxicity
Endpoint(s): Response as measured by the objective response rate (ORR: complete responses or partial responses) according to iRECIST and RECIST1.1, Clinical benefit as measured by the clinical benefit rate (CBR) according to iRECIST and RECIST1.1, PFS measured by time to event, Overall survival (OS: time from therapy initiation to death from any cause)

Source: https://euclinicaltrials.eu/ctis-public/view/2023-507875-23-00